EU clinical trial 2023-509715-91-00: A randomized, open-label, parallel-group, 18-month Phase 3 study to evaluate the effect of venglustat compared with usual standard of care on left ventricular mass index in participants with Fabry disease and left ventricular hypertrophy
Protocol code: EFC16158 - CARAT
Sponsor: Sanofi-Aventis Recherche & Developpement (Pharmaceutical company). Phase: Therapeutic confirmatory (Phase III). Countries: Italy (ongoing, recruitment ended), Greece (ended), Netherlands (ongoing, recruitment ended), Denmark (ongoing, recruitment ended), Czechia (ongoing, recruitment ended), Austria (ended), France (ongoing, recruitment ended), Germany (ongoing, recruitment ended), Poland (ongoing, recruitment ended), Norway (ongoing, recruitment ended), Spain (ongoing, recruitment ended).
Therapeutic area(s): Diseases [C] - Congenital, Hereditary, and Neonatal Diseases and Abnormalities [C16]
Gender: Female, Male. Age: 18-64 years. Enrolment: 57.
Start date (EU): 2022-05-06. Decision date: 2024-06-20. Results received: No. Last updated: 2026-05-20.
Decision dates by country: AT: 2024-06-25, GR: 2024-08-22, ES: 2024-06-21, CZ: 2024-06-24, NO: 2024-06-21, DK: 2024-06-21, IT: 2024-06-25, DE: 2024-06-24, FR: 2024-06-20, PL: 2024-06-24, NL: 2024-06-21

Condition(s): Fabry’s disease
Product: Fabrazyme 35 mg powder for concentrate for solution for infusion, venglustat GZ402671 - SAR402671, Replagal 1 mg/ml concentrate for solution for infusion., Replagal 1 mg/ml concentrate for solution for infusion., Galafold 123 mg hard capsules, Replagal 1 mg/ml concentrate for solution for infusion.

Primary endpoint: Slope of left ventricular mass index as measured by cardiac magnetic resonance imaging (MRI) (central reading)
Endpoint(s): Slope of estimated glomerular filtration rate (eGFR) as assessed by the chronic kidney disease epidemiology collaboration (CKD-EPI) creatinine equation, Change in T1 relaxation time, measured by cardiac MRI (central reading), Change in global longitudinal strain, measured by echocardiography (central reading), Percent Change in tiredness component of FDPRO, Percent Change in swelling in lower extremities component of FD-PRO, Number of participants with adverse event (AE) and serious adverse event (SAE), Change in Beck Depression Inventory-II (BDI-II) score, Change in the lens clarity by ophthalmological examination, Plasma venglustat concentrations at prespecified visits over the study duration

Source: https://euclinicaltrials.eu/ctis-public/view/2023-509715-91-00